EU clinical trial 2024-513396-41-00: CARFILZOMIB - LENALIDOMIDE - DEXAMETHASONE (KRd) versus LENALIDOMIDE - DEXAMETHASONE (Rd) IN NEWLY DIAGNOSED MYELOMA PATIENTS NOT ELIGIBLE FOR AUTOLOGOUS STEM CELL TRANSPLANTATION: A RANDOMIZED PHASE III TRIAL (EMN20)
Protocol code: EMN20
Sponsor: Fondazione European Myeloma Network Italy O.N.L.U.S. (Patient organisation/association). Phase: Therapeutic confirmatory (Phase III). Countries: Italy (ongoing, recruitment ended).
Therapeutic area(s): Diseases [C] - Neoplasms [C04]
Gender: Female, Male. Age: 18-64 years, 65+ years. Enrolment: 340.
Status: Ongoing, recruitment ended. Start date (EU): 2019-05-15. Decision date: 2024-08-12. Results received: No. Last updated: 2026-04-17.

Condition(s): PATIENTS WITH NEW DIAGNOSIS MULTIPLE MYELOMA WITH AGE >= 65 YEARS OR NOT ELIGIBLE TO ASCT
Product: Revlimid 2.5 mg hard capsules, Revlimid 5 mg hard capsules, Revlimid 15 mg hard capsules, Revlimid 20 mg hard capsules, Revlimid 10 mg hard capsules, Revlimid 25 mg hard capsules, SOLDESAM 0,2% gocce orali, soluzione, Kyprolis 60 mg powder for solution for infusion

Primary endpoint: MRD evaluation will be performed on bone marrow samples obtained after 1 and 2 years of treatment in patients who achieved at least a VGPR during the first year of study treatment. The rate of MRD negativity is determined as the patients with MRD negativity at 2 years of treatment. For patients who withdraw or are lost to follow up before two years of treatment, the best MRD assessment will be considered., PFS will be measured from the date of randomization to the date of first observation of PD, or death from any cause as an event. Subjects who withdraw from the study will be censored at the time of the last complete disease assessment. Subjects who complete the study, have not progressed, and are still alive at the cut-off date of final analysis will be censored at the cut-off date. All subjects who were lost to FU will also be censored at the time of last contact.
Endpoint(s): Response rate (sCR, CR, VGPR, PR) of experimental KRd regimen vs Rd regimen., PFS2 will be measured from the date of first randomization to the date of observation of second disease progression or death to any cause as an event. In case of date of second progression is not available, date of start of third line treatment can be used. Subjects who withdraw from the study will be considered at the time of the last complete disease assessment. Subjects who complete the study or were lost to follow-up, have no progressed, and are still alive at final analysis will be censored, TTP will be measured from the date of randomization to the date of first observation of PD, or deaths related to PD. Subjects who withdraw from the study or die from causes other than PD will be censored at the time of the last complete disease assessment. Subjects who complete the study, have not progressed, and are still alive at the cut-off date of final analysis will be censored at the cut-off date. Subjects lost to FU will also be censored at the time of last contact., DOR is defined as time between first documentation of response and PD. Responders without disease progression will be censored either at the time of lost to FU, at the time of death due to other cause than PD, or at the end of the study., OS is defined as the time between randomization and death. Subjects who die will be censored at time of death as an event, regardless cause of death. Subjects who withdraw consent will be censored at the time of withdrawal. Subjects who complete the study and are still alive at the cut-off date of final analysis will be censored at the cut-off date. Subjects lost to FU will also be censored at the time of last contact., TNT will be measured from the date of randomization to the date of next anti-myeloma therapy. Death due to any cause before starting therapy will be considered an event. Subjects who withdraw from the study will be censored at the time of the last complete disease assessment. Subjects who complete the study, have not progressed, and are still alive at the cut-off date of final analysis will be censored at the cut-off date. Subjects lost to FU will also be censored at the time of last contact., Toxicity, Quality of life defined by EOCTC QLQ-C30 and QLQ-MY20., To determine the incidence of dose reduction and drug discontinuation in both treatment arms., To determine the benefit of proper cardiovascular baseline assessment and monitoring in both treatment arms: to mitigate major cardiovascular adverse event incidence, to prolong duration of treatment, to improve efficacy., To determine the impact of MRD negativity on PFS, PFS2, TTP, TNT and OS., To determine difference of response and outcome (PFS, PFS2, TTP, TNT and OS) in subgroups analysis with different prognostic factors.

Source: https://euclinicaltrials.eu/ctis-public/view/2024-513396-41-00